EU clinical trial 2023-507221-42-00: Multicenter, Phase 3 Study of Venetoclax and Azacitidine as Maintenance Therapy for Patients with Acute Myeloid Leukemia in First Remission After Conventional Chemotherapy (VIALE-M)
Protocol code: M19-708
Sponsor: AbbVie Deutschland GmbH & Co. KG (Pharmaceutical company). Phase: Therapeutic confirmatory (Phase III). Countries: Germany (ended), Greece (ended), Czechia (ended), Hungary (ended), Italy (ended), France (ended), Spain (ended).
Therapeutic area(s): Diseases [C] - Neoplasms [C04]
Gender: Female, Male. Age: 18-64 years, 65+ years. Enrolment: 41.
Status: Ended. Start date (EU): 2020-06-03. End date (EU): 2026-02-04. End date: 2026-02-18. Decision date: 2024-02-06. Results received: No. Last updated: 2025-12-15.
Decision dates by country: DE: 2024-02-07, HU: 2024-02-06, ES: 2024-02-12, IT: 2024-02-09, CZ: 2024-02-07, GR: 2024-03-20, FR: 2024-02-28

Condition(s): Acute Myeloid Leukemia in First Remission
Product: Venetoclax, AZACITIDINE, Venetoclax, azacitidine, Venetoclax, azacitidine

Primary endpoint: Part I: The primary endpoint is dose-limiting toxicities of venetoclax in combination with AZA, Part III (Dose Finding): The primary endpoint is DLTs of venetoclax in combination with oral AZA, Part III (Randomization): Not applicable; Part 3 (Randomization) was removed from Version 6.0 of this protocol.
Endpoint(s): Part 3 (Randomization): Not applicable; Part 3 (Randomization) was removed from Version 6.0 of this protocol.

Source: https://euclinicaltrials.eu/ctis-public/view/2023-507221-42-00